EU clinical trial 2024-516116-19-00: VICTOR: Venetoclax or Intensive Chemotherapy for Treatment Of Favourable Risk Acute Myeloid Leukaemia: a molecularly guided phase 2 study
Protocol code: RG_19-282
Sponsor: The University Of Birmingham (Educational Institution). Phase: Therapeutic exploratory (Phase II). Countries: Denmark (ongoing, recruiting).
Therapeutic area(s): Diseases [C] - Neoplasms [C04]
Gender: Female, Male. Age: 18-64 years, 65+ years. Enrolment: 10.
Status: Ongoing, recruiting. Start date (EU): 2025-01-01. Decision date: 2024-10-29. Results received: No. Last updated: 2026-04-09.

Condition(s): Acute Myeloid Leukaemia
Product: CYTARABINE, Venetoclax, GEMTUZUMAB OZOGAMICIN, DAUNORUBICIN HYDROCHLORIDE

Primary endpoint: Molecular event-free survival time (mEFS). An event is defined as follows: a) Failure to achieve morphological CR or CRi after two cycles of therapy, b) Molecular persistence, progression or relapse requiring treatment change (at any time), c) Morphological relapse (at any time) or d) Death (at any time)
Endpoint(s): Occurrence of morphological complete remission (CR or CRi) by the end of the second cycle of treatment (see protocol section 8.14 for definitions of morphological response), Death within 30 and 60 days from trial entry, Overall survival time, Time to morphological relapse (see protocol section 8.14 for definitions of morphological response), Time to molecular relapse (see protocol section 8.14 for definitions of molecular response), Cumulative occurrence of grade 3 and 4 adverse events at 12 and 24 months, Prevalence of molecular complete remission at month 3, 6 and 12, Cumulative resource use at 12 and 24 months including hospital admission days, blood product usage and days on intravenous antibiotics and antifungals, Health-related quality of life at month 3, 6, 12, 18 and 24, Change in performance status from baseline at month 3, 6, 12, 18 and 24, Change in Comprehensive Geriatric Assessment (CGA) from baseline at month 12 and 24

Source: https://euclinicaltrials.eu/ctis-public/view/2024-516116-19-00